EU clinical trial 2024-516734-35-00: NeoAdjuvant Dynamic marker - Adjusted Personalized Therapy comparing sacituzumab govitecan+pembrolizumab vs. SoC chemotherapy in clinical stage II-III, triple-negative early breast cancer (ADAPT-TN-IV)
Protocol code: WSG-AM15
Sponsor: WSG Westdeutsche Studiengruppe GmbH (Pharmaceutical company). Phase: Therapeutic confirmatory (Phase III). Countries: Germany (authorised, recruitment pending).
Therapeutic area(s): Diseases [C] - Neoplasms [C04]
Gender: Female, Male. Age: 18-64 years, 65+ years. Enrolment: 690.
Status: Authorised, recruitment pending. Decision date: 2026-05-15. Results received: No. Last updated: 2026-05-15.

Condition(s): triple-negative early breast cancer
Product: KEYTRUDA 25 mg/mL concentrate for solution for infusion., Trodelvy 200 mg powder for concentrate for solution for infusion, KEYTRUDA 25 mg/mL concentrate for solution for infusion.

Primary endpoint: Primary endpoint in cohort I: • EFS after 36 months defined as time from registration to any invasive breast cancer event, death, or secondary malignancy (same definition as iDFS) according to STEEP 2.0 criteria, Primary endpoints in cohort II: • EFS after 36 months defined as time from registration to any invasive breast cancer event, death, or secondary malignancy or local progress precluding surgery in neoadjuvant treated patients • pCR defined as no invasive disease in breast and lymph nodes (ypT0/is, ypN0) in patients of both arms
Endpoint(s): Clinical response measured by palpation, ultrasound, mammography, or MRI, OS defined as time from first diagnosis to death, 3-year dDFS, 3-year RFS each as defined in STEEP 2.0, 3-year LRFS, Change of HRQoL between baseline, after completion of SoC neoadjuvant treatment, and on following defined timepoints: for details see protocol, For cohort II only: Comparison of toxicity of regimen by evaluation of treatment-emergent adverse event (TEAE), adverse drug reactions (ADR), serious ADR (SADR), and serious adverse events (SAE)-rates

Source: https://euclinicaltrials.eu/ctis-public/view/2024-516734-35-00